EU clinical trial 2023-507329-40-00: Extended treatment protocol for subjects continuing to benefit from ibrutinib after completion of ibrutinib clinical trials
Protocol code: PCYC-1145-LT
Sponsor: AbbVie Deutschland GmbH & Co. KG (Pharmaceutical company). Phase: Therapeutic use (Phase IV). Countries: Poland (ongoing, recruitment ended), Czechia (ongoing, recruitment ended), Spain (ongoing, recruitment ended), Hungary (ongoing, recruitment ended), Italy (ongoing, recruitment ended), France (ongoing, recruitment ended), Sweden (ongoing, recruitment ended).
Therapeutic area(s): Diseases [C] - Neoplasms [C04]
Gender: Female, Male. Age: 18-64 years, 65+ years. Enrolment: 125.
Status: Ongoing, recruitment ended. Start date (EU): 2017-09-28. Decision date: 2024-08-16. Results received: No. Last updated: 2026-07-13.
Decision dates by country: ES: 2024-08-20, IT: 2024-08-20, FR: 2024-08-19, SE: 2024-08-16, PL: 2024-08-29, HU: 2024-08-22, CZ: 2024-08-19

Condition(s): 1. Follicular Lymphoma; 2. Chronic Lymphocytic Leukemia; 3. Waldenstrom macroglobulinemia; 4. Multiple Myeloma; 5. Marginal Zone Lymphoma; 6. Diffuse Large B-Cell Lymphoma; 7. Urothelial Carcinoma; 8. Breast Cancer; 9. Acute Myeloid Leukemia; 10. Graft vs Host Disease; 11. Mantle Cell Lymphoma
Product: Ibrutinib

Primary endpoint: Assessment of percentage of patients rolling over from each parent study
Endpoint(s): Number of participants with treatment emergent serious adverse events and adverse events of special interest as assessed by CTCAE v4.0.

Source: https://euclinicaltrials.eu/ctis-public/view/2023-507329-40-00